EU clinical trial 2024-513054-30-00: A Phase III, Multicenter, Double-Blind, Placebo Controlled Study to Assess the Efficacy and Safety of Induction Therapy with RO7790121 in Patients with Moderately to Severely Active Crohn's Disease
Protocol code: GA45332
Sponsor: F. Hoffmann-La Roche AG (Pharmaceutical company). Phase: Therapeutic confirmatory (Phase III). Countries: Czechia (ongoing, recruiting), Italy (ongoing, recruiting), Belgium (ongoing, recruiting), Austria (ongoing, recruiting), Spain (ongoing, recruiting), Hungary (ongoing, recruiting), Poland (ongoing, recruiting), Slovakia (ongoing, recruiting), Portugal (ongoing, recruiting), Croatia (ongoing, recruiting), Germany (ongoing, recruiting), Bulgaria (authorised, recruiting), France (ongoing, recruiting), Romania (authorised, recruitment pending).
Therapeutic area(s): Phenomena and Processes [G] - Immune System Phenomena [G13]; Diseases [C] - Digestive System Diseases [C06]
Gender: Female, Male. Age: 18-64 years, 65+ years. Enrolment: 225.
Start date (EU): 2025-04-16. Decision date: 2025-04-14. Results received: No. Last updated: 2026-06-15.
Decision dates by country: IT: 2025-04-16, DE: 2025-04-22, HR: 2025-04-22, FR: 2025-04-14, PT: 2025-04-15, AT: 2025-04-22, PL: 2025-04-30, SK: 2025-04-14, RO: 2025-04-22, CZ: 2025-04-15, BE: 2025-04-30, ES: 2025-04-14, HU: 2025-04-22, BG: 2025-04-16

Condition(s): Moderately to Severely Active Crohn's Disease (CD)
Product: RO7790121, RO7790121 Placebo

Primary endpoint: 1. Clinical remission, defined as Crohn's disease activity index (CDAI) < 150, 2. Endoscopic response, defined as decrease in Simple Endoscopic Score for Crohn's disease (SES-CD) from baseline≥ 50%
Endpoint(s): 1. Symptomatic remission,, 2. Endoscopic remission,, 3. Ulcer-free endoscopy,, 4. Average of daily number of liquid or very soft stools in the past week (SF), from baseline, 5. Average of daily abdominal pain scores in the past week (APS) from baseline, 6. Bowel urgency, from baseline, 7. Fatigue, as measured by Functional Assessment of Chronic Illness Therapy-Fatigue Scale (FACIT-F), from baseline, 8. Inflammatory Bowel Disease Questionnaire (IBDQ) score, from baseline, 9. Among biomarker-defined subgroups of participants: Clinical remission, 10. Among biomarker-defined subgroups of participants: Endoscopic response, 11. Clinical response, defined as a decrease in CDAI from baseline, 12. Symptomatic response,, 13. Overall change in CD symptoms, as measured by PGIC, from baseline, 14. Overall severity in CD symptoms, as measured by Patient Global Impression of Severity (PGIS), from baseline, 15. General well-being, from baseline, 16. Incidence and severity of the following: Adverse events, 17. Incidence and severity of the following: Serious adverse events, 18. Incidence and severity of the following: Adverse events leading to study treatment discontinuation, 19. Incidence and severity of the following: Adverse events of special interest, 20. Presence of draining fistulas

Source: https://euclinicaltrials.eu/ctis-public/view/2024-513054-30-00